EU clinical trial 2022-501460-17-00: Live Attenuated Rift Valley Fever Vaccine for Single Shot Administration (LARISSA)
Protocol code: LARISSA
Sponsor: Cr2o B.V. (Pharmaceutical company). Phase: Human Pharmacology (Phase I)- First administration to humans. Countries: Belgium (ended).
Therapeutic area(s): Diseases [C] - Virus Diseases [C02]
Gender: Female, Male. Age: 18-64 years. Enrolment: 75.
Status: Ended. Start date (EU): 2022-07-26. End date (EU): 2024-12-05. Decision date: 2022-07-26. Results received: No. Last updated: 2023-09-21.

Condition(s): Rift Valley fever (RVF) infection

Source: https://euclinicaltrials.eu/ctis-public/view/2022-501460-17-00